EU clinical trial 2024-516341-39-00: A dose escalation followed by dose expansion trial to assess safety and tolerability of CAP-100 in subjects with relapsed/refractory chronic lymphocytic leukemia.
Protocol code: CAP-100-1
Sponsor: Catapult Therapeutics B.V. (Pharmaceutical company). Phase: Human Pharmacology (Phase I)- First administration to humans. Countries: Spain (ongoing, recruiting).
Therapeutic area(s): Diseases [C] - Hemic and Lymphatic Diseases [C15]
Gender: Female, Male. Age: 18-64 years, 65+ years. Enrolment: 11.
Status: Ongoing, recruiting. Start date (EU): 2021-08-23. Decision date: 2024-08-27. Results received: No. Last updated: 2026-05-11.

Condition(s): Relapsed/refractory chronic lymphocytic leukemia (CLL) or small lymphocytic lymphoma (SLL)

Source: https://euclinicaltrials.eu/ctis-public/view/2024-516341-39-00